EU clinical trial 2023-505492-68-00: AN OPEN-LABEL, EXPLORATORY STUDY OF THE SAFETY AND PRELIMINARY EFFICACY OF DANICAMTIV IN STABLE AMBULATORY PARTICIPANTS WITH PRIMARY DILATED CARDIOMYOPATHY DUE TO EITHER MYH7 OR TTN VARIANTS OR OTHER CAUSALITIES
Protocol code: CV028-005
Sponsor: Myokardia Inc. (Pharmaceutical company). Phase: Therapeutic exploratory (Phase II). Countries: Spain (ended), Germany (ended).
Therapeutic area(s): Diseases [C] - Cardiovascular Diseases [C14]
Gender: Female, Male. Age: 18-64 years, 65+ years. Enrolment: 21.
Status: Ended. Start date (EU): 2020-10-06. End date (EU): 2024-01-23. End date: 2024-02-22. Decision date: 2023-08-18. Results received: Yes. Last updated: 2024-02-05.
Decision dates by country: DE: 2023-08-18, ES: 2023-08-22

Condition(s): Primary Dilated Cardiomyopathy Due to Either MYH7 o TTN Variants
Product: Danicamtiv, Danicamtiv, Danicamtiv, Danicamtiv, Danicamtiv, Danicamtiv

Primary endpoint: Clinical safety and tolerability as assessed by the following: • Frequency of treatment-emergent adverse events and serious adverse events in Part A • Frequency of clinically significant abnormalities from vital signs, adverse events, physical examination, ECG recordings, and safety labs in Part A
Endpoint(s): Change in the following PD parameters as assessed by TTE from Baseline corresponding to Parts A and B of the study: • Left ventricular SET • Parameters of left ventricular systolic function including but not limited to left ventricular stroke volume (LVSV), LVEF, left ventricular strain (LVGLS and LVGCS) and tissue doppler imaging (TDI) of mitral valve annulus peak systolic velocity (s') will be evaluated., Change in the following PD parameters as assessed by TTE from Baseline corresponding to Parts A and B of the study:• Parameters of left ventricular dimensions including left ventricular end-systolic and end-diastolic diameters (LVESD, LVEDD), left ventricular end-systolic and end-diastolic volumes indexed for body surface area (LVEDVI, and LVESVi)., Change in the following PD parameters as assessed by TTE from Baseline corresponding to Parts A and B of the study: • Parameters of left atrial volume and function including but not limited to minimum and maximum left atrium (LA) volumes indexed for body surface area (LAmaxVi, LAminVi), left atrial emptying fraction (LAEF), and left atrial function index (LAFI), Change in the following PD parameters as assessed by TTE from Baseline corresponding to Parts A and B of the study: • Parameters of left ventricular diastolic function including but not limited to TDI of mitral valve annulus peak velocity in diastole (e', lateral,septal), ratio of peak inflow velocities in early and late diastole (E/A), ratio of early mitral peak inflow velocity to early mitral peak annulus velocity (TDI) (E/e') lateral, septal, and average

Source: https://euclinicaltrials.eu/ctis-public/view/2023-505492-68-00